EU clinical trial 2025-524134-26-00: Effect of NBI-921355 on corticospinal excitability in healthy participants
Protocol code: NBI-921355-1785
Sponsor: Neurocrine Biosciences Inc. (Pharmaceutical company). Phase: Human Pharmacology (Phase I)- Other. Countries: Netherlands (ongoing, recruiting).
Therapeutic area(s): Diseases [C] - Nervous System Diseases [C10]
Gender: Female, Male. Age: 18-64 years. Enrolment: 24.
Status: Ongoing, recruiting. Start date (EU): 2026-05-08. Decision date: 2026-04-29. Results received: No. Last updated: 2026-05-04.

Condition(s): Epilepsy

Source: https://euclinicaltrials.eu/ctis-public/view/2025-524134-26-00